EU clinical trial 2025-524019-35-00: Three-part PK and PD study of AXN-027
Protocol code: AXN-027-1101
Sponsor: Axonis Therapeutics Inc. (Pharmaceutical company). Phase: Human Pharmacology (Phase I)- Other. Countries: Netherlands (ongoing, recruiting).
Therapeutic area(s): Diseases [C] - Nervous System Diseases [C10]
Gender: Female, Male. Age: 18-64 years. Enrolment: 64.
Status: Ongoing, recruiting. Start date (EU): 2026-06-29. Decision date: 2026-06-26. Results received: No. Last updated: 2026-06-26.

Condition(s): Chronic pain, refractory epilepsy, and other neurological disorders of excitation/inhibition (E/I) imbalance within neuronal circuits.

Source: https://euclinicaltrials.eu/ctis-public/view/2025-524019-35-00